EU clinical trial 2024-515326-83-00: MILES 5 – A randomized phase 2 study comparing immunotherapy with chemotherapy in the treatment of elderly patients with advanced NSCLC
Protocol code: MILES-5
Sponsor: IRCCS Istituto Nazionale Tumori Fondazione Pascale (Hospital/Clinic/Other health care facility). Phase: Therapeutic exploratory (Phase II). Countries: Italy (ongoing, recruitment ended).
Therapeutic area(s): Diseases [C] - Neoplasms [C04]
Gender: Female, Male. Age: 65+ years. Enrolment: 240.
Status: Ongoing, recruitment ended. Start date (EU): 2018-07-31. Decision date: 2024-11-12. Results received: No. Last updated: 2026-02-23.

Condition(s): patients with advanced NSCLC
Product: VINORELBINE, DURVALUMAB, PEMETREXED, CARBOPLATIN, CISPLATIN, PACLITAXEL, GEMCITABINE

Primary endpoint: 1) 12-month overall survival 2) 4-month mortality rate
Endpoint(s): first progression-free survival (PFS) ; quality of life (EORTC C30 + LC13); toxicity profile (CTCAE 5.0 version and PRO-CTCAE); objective response rate (RECIST v.1.1. and iRECIST); second progression-free survival (PFS2)

Source: https://euclinicaltrials.eu/ctis-public/view/2024-515326-83-00